EU clinical trial 2024-513917-11-01: Prospective, multicentre, two-arms, I/II phase study to Optimise and Personalise Immunological Therapy of relapsed chronic lymphocytic leukaemia patients (OPTIC)
Protocol code: 2023/ABM/01/00072
Sponsor: Uniwersytet Medyczny W Lublinie (Educational Institution). Phase: Phase I and Phase II (Integrated)- Other. Countries: Poland (authorised, recruitment pending).
Therapeutic area(s): Diseases [C] - Hemic and Lymphatic Diseases [C15]; Diseases [C] - Neoplasms [C04]
Gender: Female, Male. Age: 18-64 years, 65+ years. Enrolment: 36.
Status: Authorised, recruitment pending. Decision date: 2026-05-29. Results received: No. Last updated: 2026-05-29.

Condition(s): Adult patients with chronic lymphocytic leukemia/small lymphocytic lymphoma (PBL) with an indication to start treatment of relapsed disease according to IWCLL recommendations.
Product: Venclyxto 100 mg film-coated tablets, Gazyvaro 1,000 mg concentrate for solution for infusion., Venclyxto 50 mg film-coated tablets, DARZALEX 1800 mg solution for injection, Venclyxto 10 mg film-coated tablets

Primary endpoint: Number of adverse events and MTD and MAD values for daratumumab in the VOD regimen group., Percentage of patients from the low and high risk groups treated with the VO regimen achieving uMRD status, i.e. MRD values <10-4 determined by flow cytometry.
Endpoint(s): PK parameters for daratumumab including Ctrough, Cmax, Tmax, T1/2 and AUC and PD defined as reduction of CD38 expression on CLL cells and regulatory cell populations, Percentage of patients achieving uMRD from the high-risk group treated with the VOD regimen, Percentage of patients achieving ORR, PR, CR and CRi, uMRD with negative prognostic factors: TP53 deletion/mutation, unmutated IGHV gene and high CD38 expression, Occurrence and correlation of ORR, PR, CR and CRi, uMRD according to potential biomarkers, including cytogenetic abnormalities detected by FISH, mutational status of the IGVH gene and TP53 mutations assessed by Sanger or next-generation sequencing (NGS), Percentage of patients achieving ORR, PR, CR and CRi, uMRD treated with new treatment regimens in relapsed patients (VO and VOD) taking into account pharmacoeconomic and systemic parameters including the number of hospitalization days and visits during 24 months, Results of the QLQ-C30 questionnaire (EORTC QLQ-C30) assessing the quality of life (QoL), completed by patients before and during treatment

Source: https://euclinicaltrials.eu/ctis-public/view/2024-513917-11-01